EU clinical trial 2023-503218-56-00: Study evaluating the efficacy of the treatment after targeting PD-L1 and TIGIT in tumors with tertiary lymphoid structures
Protocol code: 2022/3418 INDIGO
Sponsor: Institut Gustave Roussy (Hospital/Clinic/Other health care facility). Phase: Therapeutic exploratory (Phase II). Countries: France (ended).
Therapeutic area(s): Diseases [C] - Respiratory Tract Diseases [C08]
Gender: Female, Male. Age: 18-64 years, 65+ years. Enrolment: 115.
Status: Ended. Start date (EU): 2025-01-30. End date (EU): 2025-09-05. Decision date: 2024-05-23. Results received: No. Last updated: 2024-05-23.

Condition(s): Adult patients with a histologically confirmed TLS-positive advanced or metastatic NSCLC naïve from systemic treatment or previously treated with chemotherapy and PD1/PDL1 antagonist, and not having previously been treated with CD137 agonists or investigational immune checkpoint blockade therapies, including (but not limited) anti-TIGIT, anti-LAG3. Patients must have adequate organ function with a performance status (WHO 0-1; ECOG 0-1). Patients must not have active or history of autoimmune disease or immune deficiency. The pregnant or breastfeeding women will be excluded. Other eligibility criteria are described in the related section of the protocol.

Source: https://euclinicaltrials.eu/ctis-public/view/2023-503218-56-00